EU clinical trial 2024-517373-25-00: The effect of epinephrine, norepinephrine and phenylephrine on intraoperative hemodynamic performance – a prospective double-blinded randomized clinical trial
Protocol code: RACE_01
Sponsor: Medical University Of Vienna (Educational Institution). Phase: Therapeutic use (Phase IV). Countries: Austria (ongoing, recruitment ended).
Therapeutic area(s): Analytical, Diagnostic and Therapeutic Techniques and Equipment [E] - Anesthesia and Analgesia [E03]; Analytical,Diagnostic,Therapeutic Techniques and Equipment [E]-Surgical Procedures, Operative [E04]
Gender: Female, Male. Age: 18-64 years, 65+ years. Enrolment: 225.
Status: Ongoing, recruitment ended. Start date (EU): 2024-10-14. Decision date: 2024-10-14. Results received: No. Last updated: 2024-10-14.

Condition(s): Patients undergoing open major abdominal surgery
Product: Biorphen 10 mg/ml Injektionslösung, Suprarenin 1mg/ml Ampullen, Noradrenalin Kabi 1 mg/ml Konzentrat zur Herstellung einer Infusionslösung

Primary endpoint: Time weighted average (TWA) of cardiac output between continuous infusion of epinephrine, norepinephrine and phenylephrine.
Endpoint(s): Secondary outcome 1: Brain regional oxygen saturation (brSO2) – TWA of intraoperative brSO2 values between the groups, Secondary outcome 2: Tissue regional oxygen saturation (trSO2) – TWA of intraoperative trSO2 values between the groups

Source: https://euclinicaltrials.eu/ctis-public/view/2024-517373-25-00